EU clinical trial 2022-502229-16-00: Human recombinant interferon gamma in the treatment of ventilator-acquired pneumonia in ICU patients. IGNORANT study
Protocol code: 69HCL22_0851
Sponsor: Hospices Civils De Lyon (Hospital/Clinic/Other health care facility). Phase: Therapeutic confirmatory (Phase III). Countries: France (ongoing, recruiting).
Therapeutic area(s): Diseases [C] - Respiratory Tract Diseases [C08]
Gender: Female, Male. Age: 18-64 years, 65+ years. Enrolment: 132.
Status: Ongoing, recruiting. Start date (EU): 2023-06-19. Decision date: 2023-04-11. Results received: No. Last updated: 2026-04-12.

Condition(s): Ventilator acquired pneumonia
Product: CHLORURE DE SODIUM PROAMP 0,9 %, solution injectable, IMUKIN 2 X 106 UI (0,1 mg), solution injectable

Primary endpoint: mechanical ventilation-free days (VFD) from extubation through D28. A beneficial effect of using recombinant human interferon gamma-1b would be a statistically significant increase in VFD in patients receiving study drug in this setting compared to the group receiving placebo.
Endpoint(s): All-cause mortality in intensive care at D28, Bacteriological samples become negative, The occurrence of another episode of VAP before extubation, length of stay in intensive care unit, length of stay at hospital, The evolution of monocytic HLA-DR kinetics, the evolution of leukocytes kinetics, Assessment of the economic efficiency of IFN-γ administration

Source: https://euclinicaltrials.eu/ctis-public/view/2022-502229-16-00